EU clinical trial 2024-514841-12-00: PALLAS - PALbociclib CoLlaborative Adjuvant Study: A randomized phase III trial of Palbociclib with standard adjuvant endocrine therapy versus standard adjuvant endocrine therapy alone for hormone receptor positive (HR+) / human epidermal growth factor receptor 2 (HER2)-negative early breast cancer
Protocol code: AFT-05/ABCSG-42/BIG_
Sponsor: ABCSG GmbH, Alliance Foundation Trials LLC (Laboratory/Research/Testing facility, Pharmaceutical company). Phase: Therapeutic confirmatory (Phase III). Countries: Spain (ongoing, recruitment ended), Italy (ongoing, recruitment ended), Belgium (ongoing, recruitment ended), Austria (ongoing, recruitment ended), Portugal (ongoing, recruitment ended), Sweden (ongoing, recruitment ended), Poland (ongoing, recruitment ended), Ireland (ongoing, recruitment ended), Netherlands (ongoing, recruitment ended), Hungary (ongoing, recruitment ended), Germany (ongoing, recruitment ended).
Therapeutic area(s): Diseases [C] - Neoplasms [C04]
Gender: Female, Male. Age: 18-64 years, 65+ years. Enrolment: 2388.
Status: Ongoing, recruitment ended. Start date (EU): 2015-10-27. Decision date: 2024-07-17. Results received: No. Last updated: 2026-07-23.
Decision dates by country: NL: 2024-07-18, SE: 2024-07-22, IT: 2024-07-22, PL: 2024-07-22, HU: 2024-07-18, PT: 2024-07-18, DE: 2024-07-19, BE: 2024-07-18, IE: 2024-07-17, ES: 2024-07-18, AT: 2024-07-22

Condition(s): To determine whether the addition of palbociclib to adjuvant endocrine therapy will improve outcomes over endocrine therapy alone for HR+/HER2-early breast cancer.
Product: Palbociclib, Palbociclib, Palbociclib

Primary endpoint: Invasive disease-free survival (iDFS) defined acc. to STEEP criteria
Endpoint(s): (1) Invasive disease-free survival (iDFS) excl. second primary invasive cancers of non-breast origin as an event., (2) Overall Survival (OS), (3) Locoregional recurrences-free survival (LRRFS) defined as the composite of local/regional ipsilateral recurrence, contralateral invasive breast cancer or death from any cause, (4) Distant recurrence free survival (DRFS) is defined acc. to STEEP criteria as the composite of distant recurrence or death from any cause., (5) Adverse Events

Source: https://euclinicaltrials.eu/ctis-public/view/2024-514841-12-00